EU clinical trial 2023-508077-85-00: A multi-center, open-label extension study of subcutaneous secukinumab to evaluate the long-term safety and tolerability in polymyalgia rheumatica (PMR)
Protocol code: CAIN457C22301E1
Sponsor: Novartis Pharma AG (Pharmaceutical company). Phase: Therapeutic confirmatory (Phase III). Countries: Italy (ongoing, recruitment ended), Germany (ongoing, recruitment ended), Spain (ongoing, recruitment ended), Denmark (ongoing, recruitment ended), Netherlands (ongoing, recruitment ended), France (ongoing, recruitment ended), Hungary (ongoing, recruitment ended), Poland (ongoing, recruitment ended), Czechia (ongoing, recruitment ended), Belgium (ongoing, recruitment ended).
Therapeutic area(s): Diseases [C] - Musculoskeletal Diseases [C05]
Gender: Female, Male. Age: 18-64 years, 65+ years. Enrolment: 182.
Status: Ongoing, recruitment ended. Start date (EU): 2024-11-19. Decision date: 2024-06-17. Results received: No. Last updated: 2025-12-15.
Decision dates by country: CZ: 2024-06-18, DE: 2024-06-18, HU: 2024-06-19, PL: 2024-06-19, FR: 2024-06-19, BE: 2025-05-09, DK: 2024-06-17, NL: 2024-06-19, ES: 2024-06-17, IT: 2024-06-17

Condition(s): Polymyalgia Rheumatica
Product: SECUKINUMAB

Primary endpoint: Incidence of adverse events (AEs) and serious adverse events (SAEs)

Source: https://euclinicaltrials.eu/ctis-public/view/2023-508077-85-00